EU clinical trial 2024-510578-25-00: SIOP-HRMB: An international prospective trial on clinically high-risk medulloblastoma (HR-MB) in patients older than 3 years.
Protocol code: RG_18-205
Sponsor: The University Of Birmingham (Educational Institution). Phase: Therapeutic confirmatory (Phase III). Countries: Sweden (ongoing, recruiting), Czechia (authorised, recruiting), Germany (ongoing, recruiting), Austria (ongoing, recruiting), Italy (ongoing, recruiting), Finland (ongoing, recruiting), Netherlands (ongoing, recruiting), Belgium (ongoing, recruiting), Denmark (ongoing, recruiting), Norway (ongoing, recruiting).
Therapeutic area(s): Diseases [C] - Neoplasms [C04]
Gender: Female, Male. Age: 0-17 years, 18-64 years. Enrolment: 311.
Start date (EU): 2021-11-05. Decision date: 2024-11-06. Results received: No. Last updated: 2026-07-31.
Decision dates by country: AT: 2024-12-15, NL: 2024-11-06, SE: 2024-11-07, CZ: 2024-11-08, BE: 2024-11-07, DK: 2024-11-11, DE: 2024-11-08, FI: 2024-11-12, IT: 2024-11-19, NO: 2024-11-12

Condition(s): Histologically proven high-risk medulloblastoma, with any of the currently defined histological subtypes. High-risk disease is defined as patients with sonic hedgehog (SHH) subgroup or non-SHH/non-wingless-type (WNT) (Groups 3 and 4) medulloblastoma, with at least one additional high risk feature
Product: TEMOZOLOMIDE, Lomustine caps 10 mg, TEMOZOLOMIDE, TEMOZOLOMIDE, VINCRISTINE SULFATE, TEMOZOLOMIDE, CARBOPLATIN, TEMOZOLOMIDE, CYCLOPHOSPHAMIDE, LOMUSTINE, CISPLATIN, CYCLOPHOSPHAMIDE, TEMOZOLOMIDE, THIOTEPA, THIOTEPA

Primary endpoint: Event-free survival
Endpoint(s): Overall survival, Progression-free survival

Source: https://euclinicaltrials.eu/ctis-public/view/2024-510578-25-00